EU clinical trial 2023-508744-22-00: Double-blind, Randomized, Placebo-controlled Phase 3 study Evaluating Efficacy and Safety of IgPro20 (subcutaneous immunoglobulin, HIZENTRA®) in post-COVID-19 Postural Orthostatic Tachycardia Syndrome (POTS)
Protocol code: IgPro20_3010
Sponsor: CSL Behring LLC (Pharmaceutical company). Phase: Therapeutic confirmatory (Phase III). Countries: Germany (ended), Italy (ended), Spain (ended).
Therapeutic area(s): Diseases [C] - Cardiovascular Diseases [C14]
Gender: Female, Male. Age: 18-64 years, 65+ years. Enrolment: 17.
Status: Ended. End date (EU): 2025-05-13. End date: 2025-07-11. Decision date: 2025-05-07. Results received: Yes. Last updated: 2025-05-08.
Decision dates by country: DE: 2025-05-08, IT: 2025-05-07, ES: 2025-05-08

Condition(s): Post-COVID-19 Postural Orthostatic Tachycardia Syndrome
Product: Hizentra 200 mg/ml solution for subcutaneous injection, Human Albumin ”CSL Behring”, infusionsvæske, opløsning 5 %

Primary endpoint: Proportion of participants no longer meeting diagnostic criteria of post-COVID POTS as measured by standardized standing test (ie, no longer experiencing HR increase of ≥ 30 bpm, in the absence of 20 mmHg decrease of SBP [orthostatic hypotension])
Endpoint(s): Change from baseline in orthostatic intolerance score of COMPASS-31, Change from baseline in COMPASS-31 total score, Change from baseline in heart rate increase within 10 minutes of standing test, Number of participants with treatment-emergent adverse events (TEAEs), related TEAEs, serious TEAEs and related serious TEAEs, Percentage of participants with TEAEs, related TEAEs, serious TEAEs and related serious TEAEs, Number of participants with electrocardiogram (ECG) abnormalities, Percentage of participants with ECG abnormalities, Change from baseline in ECG abnormalities

Source: https://euclinicaltrials.eu/ctis-public/view/2023-508744-22-00